EU clinical trial 2024-520171-27-00: Treatment with full-spectrum cannabis extract of refractory epilepsy associated with Tuberous Sclerosis Complex (TSC): SPECTRUM
Protocol code: EstuEla2022
Sponsor: Oils4cure S.L. (Pharmaceutical company). Phase: Therapeutic confirmatory (Phase III). Countries: Spain (ongoing, recruiting).
Therapeutic area(s): Diseases [C] - Nervous System Diseases [C10]; Diseases [C] - Congenital, Hereditary, and Neonatal Diseases and Abnormalities [C16]
Gender: Female, Male. Age: 0-17 years, 18-64 years. Enrolment: 84.
Status: Ongoing, recruiting. Start date (EU): 2023-12-18. Decision date: 2025-01-13. Results received: No. Last updated: 2025-08-07.

Condition(s): Refractory epilepsy in tuberous sclerosis complex
Product: Full spectrum cannabis extract, Placebo to YCJ-01

Primary endpoint: Comparison of the number of monthly seizures since the initiation of the treatment with YCJ-01 with respect to the baseline period: in patients assigned to receive YCJ-01, change in the number of monthly seizures in the second month of treatment with respect to the baseline period; and in patient assigned to receive a placebo, changes in the number of monthly seizures in the second month of treatment with YCJ-01 with respect to the baseline period., Occurrence of Adverse Events (AE), Severe AE (SAE), AE resulting in study treatment withdrawal, AE of special interest (AESI), and changes in vital signs and laboratory values during the clinical trial. (Variable associated to the primary objective 2).
Endpoint(s): Comparison of the number of monthly epileptic seizures between the two treatment groups and the baseline period: change in number of monthly seizures of patients assigned to receive the investigational medicinal product during the second month of treatment (from visit P2 to P3) with respect of the baseline period (from visit P0 to P1), in comparison to the second month of treatment (from visit P2 to P3) to the group receiving placebo with respect to the baseline period (from visit P0 to P1)., Comparison of the number of monthly seizures since the initiation of the treatment with YCJ-01 with respect to the baseline period: in patients assigned to receive YCJ-01, change in the number of monthly seizures in the months of treatment after the second month of treatment with respect to the baseline period; and in patients assigned to receive placebo, changes in the number of monthly seizures in the months of treatment after the second month of treatment with YCJ-01 with respect to baseline, Comparison of the number of monthly seizures once the final dose was reached in P4-P5 with respect to the baseline period (from visit P0 to P1) in each of the patients. (Variable associated with primary objective 1)., Response rate to YCJ-01: patients who achieve a decrease of at least a 50 % of the number of epileptic seizures with respect to the baseline period (from visit P0 to P1) in visits P3, P4, P6, and P7 will be considered responders. (Variable associated to the secondary objective 1)., Response rate to YCJ-01in comparison to the placebo group: patients who achieve a decrease in at least a 50 % of the number of epileptic seizures with respect to the baseline period (from visit P0 to P1) in visit P3 will be considered responders. (Variable associated to the secondary objective 1)., Proportion of subjects in treatment with YCJ-01 achieving a 25%, 50%, 75%, 90% reduction in the number of epileptic seizures with respect to the baseline period (from visit P0 to P1) at visits P3, P4, P6, and P7. (Variable associated to the secondary objective 2)., Proportion of subjects in treatment with YCJ-01 compared to placebo group achieving a 25%, 50%, 75%, 90% reduction in the number of epileptic seizures with respect to the baseline period (from visit P0 to P1) at visit P3. (Variable associated to the secondary objective 2)., Proportion of patients in treatment with YCJ-01 free of epileptic seizures: defined as those participants with no seizure of any type from the initiation of the treatment with YCJ-01 till visit P7, or a period of time that doubles the baseline maximum interval between seizures (International League Against Epilepsy, ILAE). (Variable associated with the secondary objective 3)., Proportion of patients in treatment with YCJ-01 free of epileptic seizures in comparison to the placebo group: defined as those participants with no seizure of any type from the initiation of the assigned treatment till visit P7, or a period of time that doubles the baseline maximum interval between seizures (International League Against Epilepsy, ILAE). (Variable associated with the secondary objective 3)., Effect on control of epileptic seizures (variable associated to the secondary objective 4): Changes in severity and in types of epileptic seizures will be assessed after the initiation of the treatment (from visit P1 to P2, from visit P2 to P3, from visit P3 to P4, from visit P4 to P5, from visit P5 to P6, from visit P6 to P7) with respect to the baseline period (form visit P0 to P1).

Source: https://euclinicaltrials.eu/ctis-public/view/2024-520171-27-00